EU clinical trial 2022-500877-15-00: A Phase 2/3, Multicenter, Randomized, Double-blind, Placebo-Controlled, Adaptive Design Study to Evaluate the Efficacy and Safety of MK-5475 in Adults with Pulmonary Arterial Hypertension
Protocol code: MK-5475-007
Sponsor: Merck Sharp & Dohme LLC (Pharmaceutical company). Phase: Phase II and Phase III (Integrated). Countries: Greece (ended), Belgium (ended), Italy (ended), Poland (ended), France (ended), Sweden (ended), Germany (ended).
Therapeutic area(s): Diseases [C] - Cardiovascular Diseases [C14]
Gender: Female, Male. Age: 18-64 years, 65+ years. Enrolment: 68.
Status: Ended. Start date (EU): 2021-06-25. End date (EU): 2024-04-23. End date: 2024-07-02. Decision date: 2023-06-07. Results received: Yes. Last updated: 2024-04-08.
Decision dates by country: FR: 2023-06-13, BE: 2023-06-07, PL: 2023-07-07, SE: 2023-06-07, DE: 2023-07-06, GR: 2023-06-07, IT: 2023-06-09

Condition(s): Pulmonary arterial hypertension (PAH) in one of the following groups: Idiopathic PAH, Heritable PAH, Drug and toxin-induced PAH, PAH associated with connective tissue disease, HIV infection, or congenital heart disease
Product: Placebo to MK-5475

Primary endpoint: Phase 2 Cohort: Change from Baseline in Pulmonary Vascular Resistance (PVR) at 12 Weeks, Phase 3 Cohort: Change from Baseline in 6-Minute Walk Distance (6MWD) at 12 Weeks
Endpoint(s): Phase 2 Cohort: Change from Baseline in 6-Minute Walk Distance (6MWD) at 12 Weeks, Phase 2 Cohort: Change from Baseline in Mean Right Arterial Pressure (mRAP) at 12 Weeks, Phase 2 Cohort: Change from Baseline in Cardiac Index (CI) at 12 weeks, Phase 2 Cohort: Change from Baseline in Stroke Volume Index (SVI) at 12 weeks, Phase 3 Cohort: Change from Baseline in 6-Minute Walk Distance (6MWD) at 24 Weeks, Phase 3 Cohort: Change from Baseline in World Health Organization Functional Class (WHO-FC) at 12 Weeks, Phase 2 and 3 Cohorts: Number of Participants Who Experience an Adverse Event, Phase 2 and 3 Cohorts: Number of Participants Who Discontinue Study Drug Due to an Adverse Event

Source: https://euclinicaltrials.eu/ctis-public/view/2022-500877-15-00